EU clinical trial 2024-510734-41-00: An Open-label, Multi-center, Phase IV, Rollover Study for Patients with Sickle Cell Disease who have Completed a Prior Novartis-Sponsored Crizanlizumab Study
Protocol code: CSEG101A2401B
Sponsor: Novartis Pharma AG (Pharmaceutical company). Phase: Therapeutic use (Phase IV). Countries: Spain (ongoing, recruitment ended), France (ongoing, recruitment ended), Germany (ongoing, recruitment ended), Belgium (ongoing, recruitment ended), Italy (ongoing, recruitment ended).
Therapeutic area(s): Diseases [C] - Hemic and Lymphatic Diseases [C15]
Gender: Female, Male. Age: 0-17 years, 18-64 years, 65+ years. Enrolment: 22.
Status: Ongoing, recruitment ended. Start date (EU): 2021-06-10. Decision date: 2024-04-05. Results received: No. Last updated: 2026-06-23.
Decision dates by country: ES: 2024-04-05, DE: 2024-04-10, FR: 2024-04-22, BE: 2024-04-22, IT: 2024-05-20

Condition(s): Sickle cell disease
Product: SEG101

Endpoint(s): Frequency, severity and causality of treatment emergent adverse events

Source: https://euclinicaltrials.eu/ctis-public/view/2024-510734-41-00